EU clinical trial 2024-516456-17-00: Neoadjuvant Chemotherapy for Obstructive Colon cancER first Treated by cOlostomy : A randomized phase III trial - COnCERTO (French 01-18) 2019/0407/HP
Protocol code: 2019/0407/HP
Sponsor: Centre Hospitalier Universitaire Rouen (Hospital/Clinic/Other health care facility). Phase: Therapeutic confirmatory (Phase III). Countries: France (ongoing, recruiting).
Therapeutic area(s): Diseases [C] - Digestive System Diseases [C06]
Gender: Female, Male. Age: 18-64 years, 65+ years. Enrolment: 232.
Status: Ongoing, recruiting. Start date (EU): 2024-05-07. Decision date: 2024-09-26. Results received: No. Last updated: 2026-05-22.

Condition(s): patients admitted for an obstructive colon cancer
Product: ELVORINE 100 mg/10 mL, solution injectable, ELOXATINE 5 mg/ml, solution à diluer pour perfusion, FLUOROURACILE ACCORD 50 mg/ml, solution à diluer pour perfusion, OXALIPLATIN, Xeloda 150 mg film-coated tablets

Primary endpoint: the success of a full curative therapeutic

Source: https://euclinicaltrials.eu/ctis-public/view/2024-516456-17-00